EU clinical trial 2025-524761-25-00: The impact of ovarian stimulation with hMG on embryo quality in advanced age women. A randomized controlled trial
Protocol code: FSD-QUA-2025-27
Sponsor: Santiago Dexeus Font Fundacio Privada (Laboratory/Research/Testing facility). Phase: Therapeutic use (Phase IV). Countries: Spain (authorised, recruitment pending).
Therapeutic area(s): Diseases [C] - Female Urogenital Diseases and Pregnancy Complications [C13]
Gender: Female. Age: 18-64 years. Enrolment: 240.
Status: Authorised, recruitment pending. Decision date: 2026-06-23. Results received: No. Last updated: 2026-06-23.

Condition(s): infertility
Product: REKOVELLE 72 micrograms/2.16 mL solution for injection in a pre-filled pen, MENOPUR 600 UI polvo y disolvente para solución inyectable., Seidigestan 200 mg cápsulas blandas, Decapeptyl diario 0,1 mg polvo y disolvente para solución inyectable, Utrogestan 200 mg cápsulas vaginales blandas

Primary endpoint: To compare the two stimulation groups of 10 mcg/day of Follitropin delta + 150 IU hMG vs 5 mcg/day of Follitropin delta + 225 IU hMG regarding the embryo quality in advanced age women undergoing ovarian stimulation with a PPOS protocol., Fertilization rate
Endpoint(s): Total gonadotropin dose, length of stimulation, Number of oocytes retrieved, Number mature oocytes (MIIs) retrieved, Endocrine profile at specific intervals (estradiol, progesterone, FSH and LH), Follicle to Oocyte Index (FOI) (ratio between the total number of oocytes collected at the end of ovarian stimulation and the number of antral follicles available at the start of stimulation)., Follicular Output RaTe (FORT) (ratio of the number of preovulatory follicles and the number of antral follicles available at the start of stimulation)., Cycle cancelation rate, Reason for cycle cancelation, Fertilization rate, Time of appearance of the 2nd polar body (tPB2), Time of pronuclei appearance (tPNa), Evaluation of both pronuclei (PN), Time of pronuclei disappearance (tPNf), Time of division from 2 to 8 cells (t2, t3, t4, t5, t6, t7, t8), Time of compaction. (tSC), Time of morula (tM), Time of cavitation (tSB), Time of full blastulation (tB), Total number of day 5 blastocysts, Total number of euploid embryos, MII to Blastocyst formation rate, defined as the proportion of MII oocytes that reach the blastocyst stage, Number of embryos cryopreserved, Embryo stage (D5, D6, D7), Clinical pregnancy rate, defined as the visualization of one or more gestational sacs, Ongoing pregnancy rate, defined as a viable intrauterine pregnancy of at least 8-10 weeks duration confirmed on an ultrasound scan, Miscarriage rate, Live birth rate

Source: https://euclinicaltrials.eu/ctis-public/view/2025-524761-25-00